EU clinical trial 2023-504926-20-00: Effect of preventive analgesia by injection of a local anesthetic before vaginal incision for hysterectomy by the vNOTES approach: a randomized double-blind study ANOTES study
Protocol code: 2022/0270/HP
Sponsor: CHU De Rouen (Hospital/Clinic/Other health care facility). Phase: Therapeutic confirmatory (Phase III). Countries: France (ongoing, recruiting).
Therapeutic area(s): Diseases [C] - Female Urogenital Diseases and Pregnancy Complications [C13]
Gender: Female. Age: 18-64 years, 65+ years. Enrolment: 108.
Status: Ongoing, recruiting. Start date (EU): 2024-04-19. Decision date: 2023-10-24. Results received: No. Last updated: 2026-03-27.

Condition(s): Hysterectomy, hysterectomy

Source: https://euclinicaltrials.eu/ctis-public/view/2023-504926-20-00